EU clinical trial 2025-524929-41-00: Study of MX006 in Patients With Advanced and/or Metastatic Tumors known to express B7-H3
Protocol code: MX006-101
Sponsor: Myricx Pharma Limited (Pharmaceutical company). Phase: Human Pharmacology (Phase I)- First administration to humans. Countries: Spain (authorised, recruitment pending).
Therapeutic area(s): Diseases [C] - Neoplasms [C04]
Gender: Female, Male. Age: 18-64 years. Enrolment: 40.
Status: Authorised, recruitment pending. Decision date: 2026-07-20. Results received: No. Last updated: 2026-07-20.

Condition(s): Advanced Solid Tumor Types Known to Express B7-H3

Source: https://euclinicaltrials.eu/ctis-public/view/2025-524929-41-00